EU clinical trial 2025-522922-11-00: A single-center, randomized, double blind, placebo-controlled, parallel-group, proof-of-concept trial to assess the efficacy and safety of ACT-1004-1239 in adults with progressive multiple sclerosis
Protocol code: ID-086B201
Sponsor: Idorsia Pharmaceuticals Ltd. (Pharmaceutical company). Phase: Therapeutic exploratory (Phase II). Countries: Netherlands (ongoing, recruiting).
Therapeutic area(s): Diseases [C] - Nervous System Diseases [C10]
Gender: Female, Male. Age: 18-64 years. Enrolment: 32.
Status: Ongoing, recruiting. Start date (EU): 2026-03-03. Decision date: 2025-12-08. Results received: No. Last updated: 2026-05-29.

Condition(s): Progressive multiple sclerosis (MS)
Product: ACT-1004-1239 matching placebo

Primary endpoint: Change from baseline to Week 24 in myelin water fraction (MWF) of the corpus callosum
Endpoint(s): Change from baseline to Week 24 in visual evoked potential (VEP) P100 latency, Concentrations of an undisclosed molecule (commercially confidential information) in CSF at Week 12 and at Week 24, normalized to labeled body water at Week 4, Concentrations of an undisclosed molecule (commercially confidential information) in CSF at Week 12 and at Week 24, normalized to labeled body water at Week 4, Treatment-emergent adverse events (AEs), serious AEs, and AEs of special interest (e.g., suicidal ideation and/or behavior based on the Columbia Suicide Severity Rating Scale [C-SSRS©]), AEs leading to premature discontinuation of trial intervention, Change from baseline to all assessed time points during the trial in: – vital signs – body weight – laboratory variables – electrocardiogram (ECG), Treatment-emergent marked abnormalities for: – vital signs – clinical laboratory variables – ECG

Source: https://euclinicaltrials.eu/ctis-public/view/2025-522922-11-00